EU clinical trial 2024-519495-83-00: A randomized, double-blind, placebo-controlled, parallel-group study to assess the efficacy, safety, and tolerability of SAR444336 in participants with microscopic colitis in clinical remission with budesonide.
Protocol code: ACT18053
Sponsor: Sanofi-Aventis Recherche & Developpement (Pharmaceutical company). Phase: Therapeutic exploratory (Phase II). Countries: Italy (ongoing, recruiting), Sweden (ongoing, recruiting), Germany (ongoing, recruiting), France (ongoing, recruiting), Poland (ongoing, recruiting), Denmark (ongoing, recruiting), Belgium (ongoing, recruiting), Hungary (ongoing, recruiting).
Therapeutic area(s): Diseases [C] - Digestive System Diseases [C06]
Gender: Female, Male. Age: 18-64 years, 65+ years. Enrolment: 78.
Status: Ongoing, recruiting. Start date (EU): 2025-10-28. Decision date: 2025-09-29. Results received: No. Last updated: 2026-06-11.
Decision dates by country: DK: 2025-09-29, HU: 2025-10-02, IT: 2025-09-30, SE: 2025-09-30, PL: 2025-10-06, BE: 2025-10-31, DE: 2025-10-01, FR: 2025-09-29

Condition(s): Digestive system diseases
Product: Matched placebo for test product, SAR444336

Primary endpoint: Proportion of participants with sustained steroid-free clinical remission.
Endpoint(s): Incidence of treatment-emergent adverse events (TEAEs), serious adverse events (SAEs) and adverse events of special interest (AESIs)., Incidence of study investigational medicinal product (IMP) permanent discontinuations and study withdrawals due to treatment-emergent adverse events (TEAEs)., Plasma concentrations of SAR444336, Incidence of treatment-emergent anti-drug antibody (ADA) against SAR444336

Source: https://euclinicaltrials.eu/ctis-public/view/2024-519495-83-00